EU clinical trial 2023-508003-20-00: Phase 1b Study of Dato-DXd in Combination with Pembrolizumab with or without Platinum Chemotherapy in Advanced or Metastatic Non-Small Cell Lung Cancer
Protocol code: DS1062-A-U102
Sponsor: Daiichi Sankyo Inc. (Pharmaceutical company). Phase: Human Pharmacology (Phase I)- Other. Countries: Spain (ended), Italy (ended).
Therapeutic area(s): Diseases [C] - Neoplasms [C04]
Gender: Female, Male. Age: 18-64 years, 65+ years. Enrolment: 37.
Status: Ended. Start date (EU): 2021-09-27. End date (EU): 2026-05-20. Decision date: 2024-06-21. Results received: No. Last updated: 2026-04-03.
Decision dates by country: IT: 2024-06-26, ES: 2024-06-21

Condition(s): Non-small cell lung cancer

Source: https://euclinicaltrials.eu/ctis-public/view/2023-508003-20-00